EU clinical trial 2023-505376-30-00: EORTC 1612-MG: Combination of targeted therapy (encorafenib and binimetinib) followed by combination of immunotherapy (ipilimumab and nivolumab) vs immediate combination of immunotherapy in patients with unresectable or metastatic melanoma with BRAF V600 mutation: an EORTC randomized phase II study (EBIN)
Protocol code: EORTC 1612-MG
Sponsor: European Organisation For Research And Treatment Of Cancer (Patient organisation/association). Phase: Therapeutic exploratory (Phase II). Countries: Netherlands (ongoing, recruitment ended), Italy (ongoing, recruitment ended), France (ongoing, recruitment ended), Germany (ongoing, recruitment ended), Spain (ongoing, recruitment ended), Poland (ongoing, recruitment ended).
Therapeutic area(s): Diseases [C] - Neoplasms [C04]
Gender: Female, Male. Age: 18-64 years, 65+ years. Enrolment: 264.
Status: Ongoing, recruitment ended. Start date (EU): 2018-10-30. Decision date: 2024-06-25. Results received: No. Last updated: 2026-07-02.
Decision dates by country: PL: 2024-07-05, IT: 2024-07-01, DE: 2024-06-25, NL: 2024-06-28, ES: 2024-06-28, FR: 2024-06-28

Condition(s): BRAF V600 mutation–positive unresectable or metastatic melanoma
Product: YERVOY 5 mg/ml concentrate for solution for infusion, Mektovi 15 mg film-coated tablets, OPDIVO 10 mg/mL concentrate for solution for infusion., YERVOY 5 mg/ml concentrate for solution for infusion, Braftovi 75 mg hard capsules

Primary endpoint: Progression-free survival (PFS): defined as the time from the date of randomization until the first date of progression, or until date of death (whatever the cause), whichever occurs first. For patients who remain alive and whose disease has not progressed, PFS will be censored on the date of last visit/contact when a disease assessment was performed. PFS will be based on the disease assessment or date of death provided by the local investigator
Endpoint(s): Overall survival (OS): defined as the time from the date of randomization to the date of death, whatever the cause. The follow-up of patients still alive will be censored at the moment of last visit/contact, CR rate, time to CR and duration of CR, Best overall objective response (CR+PR) rate (ORR), time to best objective reponse (OR) and duration of OR

Source: https://euclinicaltrials.eu/ctis-public/view/2023-505376-30-00